EU clinical trial 2023-505857-42-00: Efficacy and safety of co-administered cagrilintide and semaglutide (CagriSema 2.4 mg/2.4 mg) once weekly versus semaglutide 2.4 mg, cagrilintide 2.4 mg and placebo in people with chronic kidney disease and type 2 diabetes living with overweight or obesity.
Protocol code: NN9388-7700
Sponsor: Novo Nordisk A/S (Pharmaceutical company). Phase: Therapeutic exploratory (Phase II). Countries: Spain (ended), Hungary (ended), Poland (ended), Greece (ended), Slovakia (ended), France (ended).
Therapeutic area(s): Not possible to specify; Diseases [C] - Nutritional and Metabolic Diseases [C18]
Gender: Female, Male. Age: 18-64 years, 65+ years. Enrolment: 308.
Status: Ended. Start date (EU): 2024-04-19. End date (EU): 2025-10-21. End date: 2025-11-07. Decision date: 2024-04-15. Results received: No. Last updated: 2026-01-13.
Decision dates by country: HU: 2024-04-17, FR: 2024-04-17, SK: 2024-04-15, ES: 2024-04-15, PL: 2024-04-22, GR: 2024-04-22

Condition(s): Chronic Kidney Disease, Type 2 diabetes
Product: cagrilintide semaglutide, Placebo + Placebo, cagrilintide semaglutide, semaglutide, cagrilintide, cagrilintide, cagrilintide semaglutide, cagrilintide semaglutide, semaglutide, semaglutide, semaglutide, FINERENONE, DAPAGLIFLOZIN, semaglutide, cagrilintide, ENALAPRIL, cagrilintide, cagrilintide, cagrilintide semaglutide

Primary endpoint: Change in UACR from baseline to end of treatment
Endpoint(s): Change in eGFR (creatinine and cystatin C-based CKD-EPI 2021) from baseline to end of treatment, Change in eGFR (creatinine-based CKD-EPI 2021) from baseline to end of treatment, Relative change in body weight from baseline to end of treatment, Achievement of ≥ 5 % weight reduction from baseline to end of treatment, Achievement of ≥ 10 % weight reduction from baseline to end of treatment, Change in waist circumference from baseline to end of treatment, Change in glycated haemoglobin (HbA1c) from baseline to end of treatment, Change in systolic blood pressure from baseline to end of treatment, Change in diastolic blood pressure from baseline to end of treatment, Number of treatment emergent adverse events (TEAEs) from baseline to end of treatment, Number of treatment emergent serious adverse events (SAEs) from baseline to end of treatment, Number of clinically significant hypoglycaemic episodes (level 2) (BG <3.0 mmol/L (54 mg/dL), confirmed by BG meter) from baseline to end of treatment, Number of severe hypoglycaemic episodes (level 3): hypoglycaemia associated with severe cognitive impairment requiring external assistance for recovery, with no specific glucose threshold from baseline to end of treatment

Source: https://euclinicaltrials.eu/ctis-public/view/2023-505857-42-00